EU clinical trial 2024-516593-30-00: Trametinib in neurofibromatosis type 1 related symptomatic plexiform neurofibromas
Protocol code: NL69517.078.19
Sponsor: Erasmus Universitair Medisch Centrum Rotterdam (Erasmus MC) (Hospital/Clinic/Other health care facility). Phase: Therapeutic exploratory (Phase II). Countries: Netherlands (authorised, recruitment pending).
Therapeutic area(s): Diseases [C] - Neoplasms [C04]; Diseases [C] - Nervous System Diseases [C10]
Gender: Female, Male. Age: 18-64 years. Enrolment: 30.
Status: Authorised, recruitment pending. Decision date: 2024-09-06. Results received: No. Last updated: 2024-09-06.

Condition(s): Neurofibromatosis type 1
Product: Mekinist 0.5 mg film-coated tablets

Primary endpoint: Tumor volume on volumetric MRI analysis
Endpoint(s): Numeric pain rating scale (NRS-11), Pain interference (PROMIS), QLQ-SF36, Medical photography, Adverse events according to CTCAEv5.0, Time to first significant progression defined as >20% volumetric growth of the index lesion(s), Incidence of surgical interventions

Source: https://euclinicaltrials.eu/ctis-public/view/2024-516593-30-00